EU clinical trial 2023-506186-57-00: An Open-Label, Multicenter Extension and Long-Term Observational Study in Patients Previously Enrolled in a Genentech-and/Or F. Hoffmann-La Roche Ltd-Sponsored Atezolizumab Study
Protocol code: BO39633
Sponsor: F. Hoffmann-La Roche AG (Pharmaceutical company). Phase: Therapeutic confirmatory (Phase III). Countries: France (ongoing, recruitment ended), Austria (ended), Spain (ended), Hungary (ended), Poland (ongoing, recruitment ended), Czechia (ended).
Therapeutic area(s): Diseases [C] - Neoplasms [C04]
Gender: Female, Male. Age: 18-64 years, 65+ years. Enrolment: 99.
Start date (EU): 2017-09-04. Decision date: 2024-02-14. Results received: No. Last updated: 2026-07-15.
Decision dates by country: CZ: 2024-05-30, HU: 2024-06-03, PL: 2024-06-03, AT: 2024-02-19, ES: 2024-02-19, FR: 2024-02-16

Condition(s): Cancer (Future parent protocols may include other cancer that are not included in this section)
Product: Tecentriq 1 200 mg concentrate for solution for infusion

Primary endpoint: N/A (Not Applicable)
Endpoint(s): Incidence and severity of serious adverse events, with severity determined according to National Cancer Institute Common Terminology Criteria for Adverse Events (NCI CTCAE), v4.0, Incidence and severity of adverse events of special interest, with severity determined according to NCI CTCAE, v4.0, Time from randomization or treatment initiation (as indicated in parent study protocol) to death due to any cause (For patients from Impower 133 only)

Source: https://euclinicaltrials.eu/ctis-public/view/2023-506186-57-00